EU clinical trial 2023-504430-22-00: A Randomized Open-label, Single Dose, 3-Period, 6-Sequence, Cross-Over Trial with Washout Periods of at least 14 days to Investigate the Relative Bioavailability of Apraglutide in Dual Chamber Syringes Versus the Reference Formulation in Vials Following Subcutaneous Administrations in Healthy Subjects
Protocol code: TA799-018
Sponsor: VectivBio AG (Pharmaceutical company). Phase: Human Pharmacology (Phase I)- Bioequivalence Study. Countries: Netherlands (ended).
Therapeutic area(s): Diseases [C] - Digestive System Diseases [C06]
Gender: Female, Male. Age: 18-64 years, 65+ years. Enrolment: 33.
Status: Ended. Start date (EU): 2023-05-23. End date (EU): 2023-09-22. Decision date: 2023-05-16. Results received: Yes. Last updated: 2023-11-29.

Condition(s): Healthy

Primary endpoint: Maximum concentration (Cmax)., Area under the curve to infinity (AUC0-inf) or the area under the curve from time zero to the last quantifiable concentration (AUClast [also called AUC0-t]), if AUC0-inf cannot be correctly estimated.
Endpoint(s): Time of maximum plasma concentration (tmax)., Terminal elimination rate constant (λz)., Terminal half-life (t1/2).

Source: https://euclinicaltrials.eu/ctis-public/view/2023-504430-22-00